EU clinical trial 2024-515046-17-00: Cognitive Function, Depression, Anxiety, and Quality of Life in Chronic Heart Failure Patients with Iron Deficiency with and without Anaemia: Effects of Intravenous Iron (Ferric Derisomaltose) CogFer-HF Study
Protocol code: Kognition
Sponsor: Universitaetsmedizin Goettingen (Hospital/Clinic/Other health care facility). Phase: Therapeutic use (Phase IV). Countries: Germany (ongoing, recruiting).
Therapeutic area(s): Diseases [C] - Cardiovascular Diseases [C14]
Gender: Female, Male. Age: 18-64 years, 65+ years. Enrolment: 40.
Status: Ongoing, recruiting. Start date (EU): 2024-08-20. Decision date: 2024-08-20. Results received: No. Last updated: 2025-07-07.

Condition(s): Heart Failure, Iron deficiency (ID), Mild Cognitive Impairment
Product: Isotone Kochsalz-Lösung 0,9 % Braun Infusionslösung, MonoFer 100 mg/ml Lösung zur Injektion/Infusion

Primary endpoint: Changes in cognitive performance at week 12, compared to baseline, as assessed by a global composite score of cognitive function. This score constitutes the average of z-standardized results of the Digit Symbol Substitution Test, Stroop Color Word Interference Task, Trailmaking-Test, CERAD-Wordlist, Digit Span Backwards Test, and Digit Span Forwards Test.
Endpoint(s): Changes in cognitive performance at week 24, compared to baseline, as assessed by the global composite score of cognitive function (single items for composite score see 3.2.1 Primary Endpoint)., Changes in single measures and domain specific subscores (e.g. frontal executive function, perceptual speed, memory subsystems) of cognitive performance at week 12 and 24 compared to baseline, as assessed by the MoCA Test, Digit Symbol Substitution Test, Stroop Color Word Interference Task, Trailmaking-Test, CERAD- Wordlist, Digit Span Backwards Test, and Digit Span Forwards Test., Reduction in depression from baseline to week 12 and 24, as assessed by HADS, Reduction in general anxiety and heart-focused anxiety from baseline to week 12 and 24, as assessed by HADS and HAF-17., Changes in self-reported quality of life, as assessed by The Kansas City Cardiomyopathy Questionnaire (for HF specific quality of life) and EQ-5D (for general psychological and physical quality of life) from baseline to week 12 and 24.

Source: https://euclinicaltrials.eu/ctis-public/view/2024-515046-17-00